EU clinical trial 2024-515546-16-00: Phase Ib Clinical Trial to Evaluate the Safety Profile of the Combination Tilray FS Oral Solution T10:C10 with Temozolomide and Radiotherapy in Patients With Newly Diagnosed Glioblastoma.
Protocol code: GEINO -1601
Sponsor: Grupo Espanol De Investigacion En Neurooncologia (Laboratory/Research/Testing facility). Phase: Human Pharmacology (Phase I)- Other. Countries: Spain (ended).
Therapeutic area(s): Diseases [C] - Neoplasms [C04]
Gender: Female, Male. Age: 18-64 years, 65+ years. Enrolment: 33.
Status: Ended. Start date (EU): 2024-08-27. End date (EU): 2025-11-12. Decision date: 2024-08-27. Results received: No. Last updated: 2024-08-27.

Condition(s): Glioblastoma

Source: https://euclinicaltrials.eu/ctis-public/view/2024-515546-16-00